EU clinical trial 2024-519856-94-00: A Phase 2b, Randomized, Double-Blind, Placebo-Controlled, Multicenter Study to Evaluate Nebulized Bacteriophage Treatment in Outpatient Adult Cystic Fibrosis (CF) Subjects with Chronic Pseudomonas aeruginosa (PsA) Pulmonary Infection
Protocol code: BMX-04-002
Sponsor: Biomx Ltd. (Pharmaceutical company). Phase: Therapeutic exploratory (Phase II). Countries: Germany (ended), Ireland (ended), France (ended), Czechia (ended), Italy (ended), Netherlands (ended), Poland (ended), Spain (ended).
Therapeutic area(s): Diseases [C] - Respiratory Tract Diseases [C08]
Gender: Female, Male. Age: 18-64 years, 65+ years. Enrolment: 40.
Status: Ended. Start date (EU): 2025-08-18. End date (EU): 2025-12-08. End date: 2025-12-09. Decision date: 2025-08-04. Results received: Yes. Last updated: 2025-10-06.
Decision dates by country: NL: 2025-08-11, PL: 2025-08-11, FR: 2025-08-06, IE: 2025-08-08, ES: 2025-08-06, CZ: 2025-08-04, IT: 2025-08-04, DE: 2025-08-06

Condition(s): Cystic fibrosis
Product: BX004, BX004 Placebo

Primary endpoint: Change from baseline in PsA CFU/g of sputum at 8 weeks of treatment (D57 [EOT])
Endpoint(s): Change from baseline in lung function (% predicted FEV1) at study visits, Change from baseline in quality of life assessments, using: o Cystic Fibrosis Questionnaire - Revised (CFQ-R) respiratory domain, and o Cystic Fibrosis Respiratory Symptom Diary and Chronic Respiratory Infection Symptom Score (CFRSD-CRISS), Change from baseline in PsA CFU/g of sputum at study visits, Efficacy of BX004 on sputum culture conversion, Incidence of treatment-emergent adverse events and change in vital signs, lung exam, blood tests and spirometry

Source: https://euclinicaltrials.eu/ctis-public/view/2024-519856-94-00